EU clinical trial 2024-513582-39-01: Preincisional versus postincisional ultrasound-guided transversus abdominis plane (TAP) block comparative effect on chronic postsurgical pain in patients undergoing open inguinal hernia mesh repair
Sponsor: Hospital Central De La Defensa Gomez Ulla (Hospital/Clinic/Other health care facility). Phase: Therapeutic use (Phase IV). Countries: Spain (ongoing, recruiting).
Therapeutic area(s): Analytical, Diagnostic and Therapeutic Techniques and Equipment [E] - Therapeutics [E02]; Diseases [C] - Nervous System Diseases [C10]
Gender: Female, Male. Age: 18-64 years, 65+ years. Enrolment: 70.
Status: Ongoing, recruiting. Start date (EU): 2024-09-20. Decision date: 2024-08-12. Results received: No. Last updated: 2024-08-12.

Condition(s): Chronic postsurgical pain after open inguinal hernia mesh repair
Product: LEVOBUPIVACAINE

Primary endpoint: Prevention of chronic postsurgical pain in patients udergoing open inguinal hernia mesh repair with the use of a TAP block
Endpoint(s): Decrease in the chronic use of analgesic drugs in patients undergoing open inguinal hernia mesh repair with the use of a TAP block

Source: https://euclinicaltrials.eu/ctis-public/view/2024-513582-39-01